EU clinical trial 2025-523258-15-00: J2J-MC-JZLL - preEMBER: A Phase 2, Open-label Study Evaluating Imlunestrant in Premenopausal Women with Estrogen Receptor-Positive, HER2-Negative Breast Cancer.
Protocol code: J2J-MC-JZLL
Sponsor: Eli Lilly & Co. (Pharmaceutical company). Phase: Therapeutic exploratory (Phase II). Countries: Belgium (authorised, recruitment pending), France (authorised, recruitment pending), Italy (authorised, recruitment pending), Germany (authorised, recruiting).
Therapeutic area(s): Diseases [C] - Neoplasms [C04]
Gender: Female. Age: 18-64 years, 65+ years. Enrolment: 361.
Start date (EU): 2026-08-04. Decision date: 2026-07-21. Results received: No. Last updated: 2026-07-23.
Decision dates by country: BE: 2026-07-23, FR: 2026-07-21, DE: 2026-07-21, IT: 2026-07-23

Condition(s): Breast Neoplasms
Product: TAMOXIFEN, GOSERELIN

Primary endpoint: Change from Baseline in Antigen Kiel (Ki-67) Expression., Rate of Symptomatic Ovarian Cysts.

Source: https://euclinicaltrials.eu/ctis-public/view/2025-523258-15-00